EU clinical trial 2023-503958-12-00: Prospective, open-label study to analyze the efficacy and safety of low-dose oral immunotherapy in children with severe IgE-mediated cow's milk allergy treated with omalizumab. ILO study.
Sponsor: Hospital Infantil Universitario Nino Jesus (Hospital/Clinic/Other health care facility). Phase: Therapeutic exploratory (Phase II). Countries: Spain (authorised, recruitment pending).
Therapeutic area(s): Diseases [C] - Immune System Diseases [C20]
Gender: Female, Male. Age: 0-17 years. Enrolment: 20.
Status: Authorised, recruitment pending. Decision date: 2023-09-15. Results received: No. Last updated: 2025-05-19.

Condition(s): Severe IgE-mediated cow's milk allergy
Product: Xolair 75 mg solution for injection in pre-filled syringe, Xolair 150 mg solution for injection in pre-filled syringe

Primary endpoint: Proportion of subjects tolerating 300 mg cow's milk protein with no symptoms or only Grade 1 symptoms (oFASS-5) in the double-blind placebo-controlled oral cow's milk challenge trial (DBPCOC) without Omalizumab (without-Oz).
Endpoint(s): • Proportion of subjects tolerating the 300 mg dose of cow's milk protein with no or only Grade 1 symptoms (oFASS-5) in the double-blind placebo-controlled oral cow's milk challenge test (DBPCOC) at 4 months from initiation Omalizumab (Oz1). • Proportion of subjects tolerating >300 mg cow's milk protein with no or only Grade 1 symptoms (oFASS-5) in the open cow's milk oral challenge test (Oz1-a).

Source: https://euclinicaltrials.eu/ctis-public/view/2023-503958-12-00